EU clinical trial 2024-513740-28-00: A Phase 3, Global, Randomized, Modified Double-Blind, Placebo‑Controlled, Study to Evaluate the Efficacy, Immunogenicity, and Safety of IVX-A12, a Respiratory Syncytial Virus (RSV) and Human Metapneumovirus (hMPV) Virus-Like Particle (VLP) Vaccine in Adults 60 Years of Age and Older.
Protocol code: D8610C00001
Sponsor: AstraZeneca AB, Icosavax Inc. (Pharmaceutical company). Phase: Therapeutic confirmatory (Phase III). Countries: Spain (authorised, recruitment pending), Estonia (authorised, recruitment pending), Bulgaria (authorised, recruitment pending), Germany (authorised, recruitment pending), Finland (authorised, recruitment pending), Poland (authorised, recruitment pending), Sweden (authorised, recruitment pending), Belgium (authorised, recruitment pending).
Therapeutic area(s): Diseases [C] - Respiratory Tract Diseases [C08]
Gender: Female, Male. Age: 18-64 years, 65+ years. Enrolment: 3714.
Status: Authorised, recruitment pending. Decision date: 2024-11-11. Results received: No. Last updated: 2024-11-18.
Decision dates by country: ES: 2024-11-13, FI: 2024-11-11, SE: 2024-11-11, BE: 2024-11-11, BG: 2024-11-11, EE: 2024-11-18, DE: 2024-11-12, PL: 2024-11-18

Condition(s): Respiratory Syncytial Virus and Human Metapneumovirus
Product: Placebo is 0.9% (w/v) NaCl for injection and is to be provided by sites., IVX-A12

Primary endpoint: Occurrence of the first RSV-confirmed LRTD (confirmed RSV A and/or B associated LRTD) starting on Day 15 during the first season, Occurrence of the first hMPV-confirmed LRTD (confirmed hMPV A and/or B associated LRTD) starting on Day 15 during the first season
Endpoint(s): Occurrence of the first RSV-confirmed LRTD (confirmed RSV A and/or B associated LRTD) starting on Day 15 over two seasons, Occurrence of the first hMPV-confirmed LRTD (confirmed hMPV A and/or B associated LRTD) starting on Day 15 over two seasons, Occurrence of the first RSV-confirmed severe LRTD (confirmed RSV A and/or B associated LRTD) starting on Day 15 over two seasons, Occurrence of the first hMPV-confirmed severe LRTD (confirmed hMPV A and/or B associated LRTD) starting on Day 15 over two seasons

Source: https://euclinicaltrials.eu/ctis-public/view/2024-513740-28-00